EU clinical trial 2024-512211-41-00: A Phase 2 clinical study to assess efficacy of Induction ipilimumab/nivolumab to spare the Bladder in urothelial bladder cancer (Indi-Blade)
Protocol code: M21IDB
Sponsor: Het Nederlands Kanker Instituut-Antoni van Leeuwenhoek Ziekenhuis Stichting (Hospital/Clinic/Other health care facility). Phase: Phase I and Phase II (Integrated)- Other. Countries: Netherlands (ongoing, recruitment ended).
Therapeutic area(s): Diseases [C] - Male Urogenital Diseases [C12]; Diseases [C] - Female Urogenital Diseases and Pregnancy Complications [C13]
Gender: Female, Male. Age: 18-64 years, 65+ years. Enrolment: 50.
Status: Ongoing, recruitment ended. Start date (EU): 2022-01-26. Decision date: 2024-10-10. Results received: No. Last updated: 2024-10-10.

Condition(s): Urothelial carcinoma of the bladder and bladder cancer
Product: NIVOLUMAB, IPILIMUMAB

Primary endpoint: efficacy defined as bladder-intact event-free survival (BI-EFS). Events consist of death by any cause; muscle-invasive recurrence in the bladder or in the ureter, distal of the crossing with the common iliac artery, nodal or distant recurrence, cystectomy, or switch to cisplatin-based chemotherapy.
Endpoint(s): Overall survival (OS), recurrence-free survival (RFS), feasibility to proceed to CRT, safety, predictive value of ctDNA, QoL, and bladder function

Source: https://euclinicaltrials.eu/ctis-public/view/2024-512211-41-00